EU clinical trial 2023-507367-18-00: Open label randomized, multicentre, controlled trial of pancreatic enzyme replacement therapy (PERT) for pancreatic exocrine insufficiency (PEI) in patients with unresectable pancreatic cancer.
Sponsor: Fundacion Instituto De Investigacion Sanitaria De Santiago De Compostela (Patient organisation/association). Phase: Therapeutic use (Phase IV). Countries: Spain (ongoing, recruiting), France (not authorised), Italy (ongoing, recruiting), Sweden (ongoing, recruiting).
Therapeutic area(s): Diseases [C] - Digestive System Diseases [C06]
Gender: Female, Male. Age: 18-64 years, 65+ years. Enrolment: 80.
Start date (EU): 2024-02-14. Decision date: 2023-08-03. Results received: No. Last updated: 2026-08-04.
Decision dates by country: IT: 2024-09-13, SE: 2024-09-09, ES: 2023-08-03

Condition(s): Pancreatic exocrine insufficiency
Product: Kreon 35 000 U cápsulas duras gastrorresistentes

Primary endpoint: The primary endpoint is defined as the change in body weight (kg and percentage) from baseline to the end of the controlled phase, 3 months from inclusion, as well as to the end of the study, 6 months from inclusion, in the two groups of patients.
Endpoint(s): Change in haemoglobin, lymphocytes, serum concentration of nutritional markers (albumin, prealbumin, retinol binding protein, transferrin, fat-soluble vitamins, total and HDL cholesterol, triglycerides, cholinesterase, magnesium, selenium, and zinc), HbA1C and C-reactive protein (CRP) from baseline to the end of the controlled phase (3 months) and the end of the study (6 months) in the two groups of patients, Change in Karnofsky performance status from baseline to the end of the controlled phase and the end of the study in the two groups of patients, Change in malabsorption-related symptoms (diarrhoea, flatulence, abdominal distention, meteorism, abdominal cramps) and Patient-Generated Subjective Global Assessment (PG-SGA) from baseline to the end of the controlled phase and the end of the study in the two groups of patients, Change in quality of life (EORTC QLQ-PAN26) from baseline to the end of the controlled phase and the end of the study in the two groups of patients, Tolerance to chemotherapy defined as the percentage of the optimal dose of chemotherapeutic agents administered at months 3 and 6 from inclusion, Survival over 3 and 6 months from inclusion

Source: https://euclinicaltrials.eu/ctis-public/view/2023-507367-18-00